EU clinical trial 2024-513147-90-00: A Phase 3, Multicenter, Open-Label, Long-Term Trial to Evaluate the Safety and Efficacy of Efgartigimod (ARGX-113) PH20 Subcutaneous in Adult Patients With Primary Immune Thrombocytopenia
Protocol code: ARGX-113-2005
Sponsor: Argenx (Pharmaceutical company). Phase: Therapeutic confirmatory (Phase III). Countries: Italy (ongoing, recruitment ended), Romania (ended), Greece (ongoing, recruitment ended), Bulgaria (ongoing, recruitment ended), Portugal (ongoing, recruitment ended), Norway (ended).
Therapeutic area(s): Diseases [C] - Hemic and Lymphatic Diseases [C15]
Gender: Female, Male. Age: 18-64 years, 65+ years. Enrolment: 20.
Start date (EU): 2022-04-26. Decision date: 2024-07-19. Results received: No. Last updated: 2026-02-04.
Decision dates by country: GR: 2024-07-24, PT: 2024-07-19, RO: 2024-08-12, NO: 2024-07-19, IT: 2024-07-24, BG: 2024-07-19

Condition(s): Primary Immune Thrombocytopenia
Product: ARGX-113

Primary endpoint: Incidence, frequency, and severity of adverse events (AEs), AEs of special interest (AESIs), and serious AEs (SAEs), Vital signs, electrocardiogram (ECG), and laboratory safety evaluations
Endpoint(s): First 52-week treatment period only: Extent of disease control defined as the percentage of weeks in the trial with platelet counts of ≥50×10^9/L, First 52-week treatment period only: Proportion of participants with overall platelet count response defined as achieving a platelet count of ≥50×10^9/L on at least 4 occasions at any time during the 52-week treatment period, First 52-week treatment period only: Mean change from baseline in platelet count at each visit, First 52-week treatment period only: For participants rolling over from the ARGX-113-2004 trial with a platelet count of <30×10^9/L: time to response defined as the time to achieve 2 consecutive platelet counts of ≥50×10^9/L, First 52-week treatment period only: The percentage of weeks in the trial with platelet counts of ≥ 30×10^9/L and ≥20×10^9/L above baseline, First 52-week treatment period only: In patients with a baseline platelet count of <15×10^9/L in the current trial (ARGX-113-2005), the percentage of weeks in the trial with platelet counts of ≥30×10^9/L and ≥20×10^9/L above baseline, First 52-week treatment period only: In participants with the first exposure to efgartigimod PH20 SC, the proportion of participants who achieve a sustained platelet response defined as achieving platelet counts of ≥50×10^9/L for at least 4 of the 6 visits between week 19 and week 24, First 52-week treatment period only: In participants with the first exposure to efgartigimod PH20 SC, the proportion of participants achieving platelet counts of ≥50×10^9/L for at least 6 of the 8 visits between week 17 and week 24, First 52-week treatment period only: Proportion of participants for whom dose and/or frequency of concurrent ITP therapies have been reduced compared to baseline, First 52-week treatment period only: Rate of receipt of rescue therapy (rescue per participant per month), First 52-week treatment period only: Incidence and severity of the World Health Organization (WHO)-classified bleeding events, First 52-week treatment period only: Serum efgartigimod concentration observed predose (Ctrough), First 52-week treatment period only: Change from baseline in PRO (Functional Assessment of Chronic Illness Therapy Fatigue Scale [FACIT-fatigue], Functional Assessment of Cancer Therapy questionnaire-Th6 [FACT-Th6]), QoL (Short Form-36 [SF-36]), and ITP-Patient Assessment Questionnaire [ITP-PAQ] at planned visits, First 52-week treatment period only: PD markers: total IgG, First 52-week treatment period only: Number and percentage of participants who performed self-administration at home over time, First 52-week treatment period only: Number and percentage of caregivers who administered the injection to the participant at home over time, First 52-week treatment period only: Number of training visits needed for the participant or caregiver to become competent in the (self-)administration of efgartigimod PH20 SC, First 52-week treatment period only: Number and percentage of self-administrations or caregiver-supported administrations at home First 52-week treatment period and additional 52-week treatment periods, First 52-week treatment period and additional 52-week treatment periods: Incidence and prevalence of antibodies to efgartigimod, First 52-week treatment period and additional 52-week treatment periods: Titers of antibodies to efgartigimod, First 52-week treatment period and additional 52-week treatment periods: Presence of neutralizing antibodies (NAb) against efgartigimod

Source: https://euclinicaltrials.eu/ctis-public/view/2024-513147-90-00